EU clinical trial 2023-503826-37-00: A randomized, double-blind, phase 3 study of tucatinib or placebo in combination with trastuzumab and pertuzumab as maintenance therapy for metastatic HER2+ breast cancer (HER2CLIMB-05)
Protocol code: SGNTUC-028
Sponsor: Seagen Inc. (Pharmaceutical company). Phase: Therapeutic confirmatory (Phase III). Countries: Poland (ongoing, recruitment ended), Belgium (ongoing, recruitment ended), Czechia (ongoing, recruitment ended), France (ongoing, recruitment ended), Austria (ongoing, recruitment ended), Germany (ongoing, recruitment ended), Italy (ongoing, recruitment ended), Greece (ongoing, recruitment ended), Spain (ongoing, recruitment ended), Portugal (ongoing, recruitment ended), Finland (ongoing, recruitment ended), Netherlands (ongoing, recruitment ended).
Therapeutic area(s): Diseases [C] - Neoplasms [C04]
Gender: Female, Male. Age: 18-64 years, 65+ years. Enrolment: 270.
Status: Ongoing, recruitment ended. Start date (EU): 2022-02-11. Decision date: 2024-04-24. Results received: No. Last updated: 2026-06-29.
Decision dates by country: BE: 2024-04-24, FI: 2024-04-24, IT: 2024-04-30, GR: 2024-06-04, PL: 2024-04-24, AT: 2024-04-26, ES: 2024-04-29, DE: 2024-05-13, FR: 2024-04-24, CZ: 2024-04-24, PT: 2024-04-24, NL: 2024-04-24

Condition(s): Unresectable locally-advanced or metastatic HER2+ breast cancer
Product: Tucatinib 150mg placebo tablets, Tucatinib 50mg placebo tablets, TUKYSA 150 mg film-coated tablets, TUKYSA 50 mg film-coated tablets, Phesgo 600 mg/600 mg solution for injection

Primary endpoint: PFS, defined as the time from randomization to investigator-assessed documented disease progression per RECIST v1.1, or death from any cause, whichever occurs first
Endpoint(s): OS, defined as the time from randomization to death from any cause, PFS, defined as the time from randomization to documented disease progression (as determined by BICR per RECIST v1.1), or death from any cause, whichever occurs first, Time to deterioration of HRQoL, defined as time to 10-point decrease in the global health status/QoL scale of the European Organization for Research and Treatment of Cancer (EORTC) quality-of-life questionnaire (QLQ-C30), - Central nervous system (CNS)-PFS, defined as the time from randomization to investigator-assessed disease progression in brain (RECIST v1.1), or death from any cause, whichever occurs first, Adverse events (AEs), Clinical laboratory assessments, Incidence of dose holding, dose reductions, and discontinuations of tucatinib, Incidence of dose holding and discontinuations of trastuzumab, Incidence of dose holding and discontinuations of Pertuzumab, Plasma concentrations of tucatinib

Source: https://euclinicaltrials.eu/ctis-public/view/2023-503826-37-00